EU clinical trial 2024-512685-33-00: Anticoagulant Regimens Given to achieve thrombus regression and reduce clinical Outcomes among patients with Non device-related intra-cardiac thrombus: a randomized Assessment Under direct oral anticoagulant and vitamin K antagonist Therapy – the ARGONAUT trial
Protocol code: PHRC-N/2020/BL-01
Sponsor: Centre Hospitalier Universitaire De Nimes (Hospital/Clinic/Other health care facility). Phase: Therapeutic confirmatory (Phase III). Countries: France (ongoing, recruitment ended).
Therapeutic area(s): Diseases [C] - Cardiovascular Diseases [C14]
Gender: Female, Male. Age: 18-64 years, 65+ years. Enrolment: 340.
Status: Ongoing, recruitment ended. Start date (EU): 2023-04-11. Decision date: 2024-05-14. Results received: No. Last updated: 2026-02-06.

Condition(s): intra-cardiac thrombus
Product: RIVAROXABAN, PREVISCAN 20 mg comprimé quadrisécable, DABIGATRAN ETEXILATE, WARFARIN, APIXABAN, ACENOCOUMAROL

Primary endpoint: Net clinical benefit endpoint at 6 months: composite endpoint of all-cause death, myocardial infarction, stroke, acute peripheral emboli, acute pulmonary embolism, thrombus persistence and clinically relevant bleedings (Bleeding Academic Research Consortium 2, 3 and 5).
Endpoint(s): - Secondary efficacy endpoints: o All individual components of the composite ischemic endpoint at 6 and 12 months o Systemic embolism defined by the composite of stroke, embolic myocardial infarction, peripheral artery occlusion and acute pulmonary embolism at 6 and 12 months o Cardiovascular death at 6 and 12 months o Total thrombus regression at 6 and 12 months o Thrombus recurrence at different cardiac imaging follow-up, - Secondary safety endpoints: o Clinically relevant bleedings (international Bleeding Academic Research Consortium (BARC) types 2 to 5) at 6 and 12 months o Major bleedings (BARC 3 to 5) at 6 and 12 months

Source: https://euclinicaltrials.eu/ctis-public/view/2024-512685-33-00